EU clinical trial 2023-505606-42-00: A Multicenter, Randomized, Double-Blind, Placebo-Controlled Phase 3 Study of Ficlatuzumab in Combination with Cetuximab in Participants with Recurrent or Metastatic (R/M) HPV-Negative Head and Neck Squamous Cell Carcinoma (FIERCE-HN)
Protocol code: AV-299-23-301
Sponsor: Aveo Pharmaceuticals Inc. (Pharmaceutical company). Phase: Therapeutic confirmatory (Phase III). Countries: Spain (ongoing, recruiting), Netherlands (ongoing, recruiting), Belgium (ongoing, recruiting), Poland (ongoing, recruiting), France (ongoing, recruiting), Czechia (ongoing, recruiting), Italy (ongoing, recruiting), Bulgaria (ended), Romania (ongoing, recruiting), Germany (ongoing, recruiting), Hungary (ongoing, recruiting).
Therapeutic area(s): Diseases [C] - Neoplasms [C04]
Gender: Female, Male. Age: 18-64 years, 65+ years. Enrolment: 204.
Start date (EU): 2024-10-15. Decision date: 2024-04-16. Results received: No. Last updated: 2026-04-20.
Decision dates by country: BG: 2024-04-22, RO: 2024-04-19, HU: 2024-04-17, NL: 2024-04-16, BE: 2024-04-16, IT: 2024-04-18, FR: 2024-04-22, PL: 2024-04-22, DE: 2024-04-19, CZ: 2024-04-17, ES: 2024-04-16

Condition(s): Head and Neck Squamous Cell Carcinoma (HNSCC)
Product: Erbitux 5 mg/mL solution for infusion, Ficlatuzumab, Ficlatuzumab, The corresponding placebo for this study is 0.9% Sodium Chloride injection for intravenous administration and this will be provided by the study site (and reimbursed by the Sponsor).

Primary endpoint: Overall survival (OS), defined as the time from the date of randomization to the date of death for any cause
Endpoint(s): 1. PFS defined as the time from randomization to the first documented progressive disease (PD) per Response Evaluation Criteria in Solid Tumors, version 1.1 (RECIST v1.1) as assessed by the investigator, or death from any cause, whichever occurs first, 2. ORR defined as the percentage of participants who have a complete response (CR) or a partial response (PR) per RECIST v1.1 as assessed by the investigator, 3. DCR defined as the percentage of participants who have achieved a CR, PR, or stable disease (SD) for at least 8 weeks per RECIST v1.1 (as assessed by the investigator), 4. Duration of response (DOR), defined for participants who have a confirmed CR or PR as the time from the date of first documented response (which is subsequently confirmed) per RECIST v1.1, as assessed by the investigator, until date of documented PD or death due to any cause, whichever occurs first, 5. Incidence and severity of adverse events (AEs); Incidence and severity of laboratory abnormalities, 6. Concentrations of ficlatuzumab in serum samples, 7. The presence of antidrug antibodies (ADA) to ficlatuzumab based on seroconversion status, and the evaluation of the potential impact of ADA on PK, efficacy, and safety • The presence of neutralizing antibodies, when ADA is positive, and the evaluation of the potential interference of ADA on ficlatuzumab-HGF binding, 8. Change from baseline in the European Organisation for the Research and Treatment of Cancer (EORTC) QLQ-Head and Neck Module 35 (H&N35) • Time to clinically meaningful deterioration in scores on the EORTC H&N35 • Change from baseline in overall health status per the EuroQol-5 dimensions-3 level (EQ-5D-3L)

Source: https://euclinicaltrials.eu/ctis-public/view/2023-505606-42-00